EU clinical trial 2024-519691-10-00: Hemodynamic Phenotype-Based,Capillary Refill Time-Targeted Resuscitation In Early Septic Shock:ANDROMEDA-SHOCK-2
Protocol code: ANDROMEDA-SHOCK-2
Sponsor: Pontificia Universidad Catolica de Chile (Educational Institution). Phase: Therapeutic use (Phase IV). Countries: Spain (ended).
Therapeutic area(s): Phenomena and Processes [G] - Physiological processes [G07]; Analytical, Diagnostic and Therapeutic Techniques and Equipment [E] - Therapeutics [E02]; Diseases [C] - Pathological Conditions, Signs and Symptoms [C23]
Gender: Female, Male. Age: 18-64 years, 65+ years. Enrolment: 500.
Status: Ended. Start date (EU): 2022-05-27. End date (EU): 2025-07-28. Decision date: 2025-01-23. Results received: Yes. Last updated: 2025-01-23.

Condition(s): Septic Shock
Product: Suero Fisiológico Vitulia 0,9 % solución para perfusión, Lactato Ringer Braun, solução para perfusão

Primary endpoint: The primary outcome is a hierarchical composite of all cause mortality within 28 days, time to cessation of vital support (truncated at 28 days) and length of hospital stay (truncated at 28 days).
Endpoint(s): All-cause mortality within 28 days (Time Frame: 28days)

Source: https://euclinicaltrials.eu/ctis-public/view/2024-519691-10-00